EU clinical trial 2024-516089-12-00: Assisted reproductive technology (ART) and pregnancy outcomes in women with adenomyosis (internal endometriosis) according to stimulation protocol in relation to immunological and endometrial features: a prospective, randomized study
Protocol code: ADENOFERT
Sponsor: Azienda Ospedaliero Universitaria Di Modena (Hospital/Clinic/Other health care facility). Phase: Therapeutic use (Phase IV). Countries: Italy (ongoing, recruiting).
Therapeutic area(s): Diseases [C] - Female Urogenital Diseases and Pregnancy Complications [C13]
Gender: Female. Age: 18-64 years. Enrolment: 500.
Status: Ongoing, recruiting. Start date (EU): 2024-08-12. Decision date: 2024-08-12. Results received: No. Last updated: 2025-04-04.

Condition(s): women with transvaginal ultrasound (TV-US)-based diagnosis of adenomyosis, women without adenomyosis but with similar baseline reproductive risks
Product: LEUPRORELIN

Primary endpoint: To prospectively investigate the association of Adenomyosis with fertility outcomes in relation to COH protocols for ART (long or ultra-long protocol) with a preventive high-dose anti-inflammatory progestin such as dienogest (DNG).
Endpoint(s): To evaluate the association of COH (Controlled Ovarian Hyperstimulation) protocols for ART (long or ultra-long protocol) with a high-dose preventive anti-inflammatory progestogen such as DNG with pregnancy and neonatal outcomes (preterm delivery, preeclampsia, cesarean section, fetal malformation, SGA, low birth weight and postpartum haemorrhage)., Secondary in-vitro sub-studies: Stimulated (P and DNG) markers of decidualization (osteopontin, prolactin) in relation to ART success in women with and without A. Immune system cell population and relative cytokines, the frequency of immune system cells, the interleukin profile, cell activity, specific receptors of pregnancy hormone involved in T cell activity in women with A in comparison to healthy subjects.

Source: https://euclinicaltrials.eu/ctis-public/view/2024-516089-12-00